EU clinical trial 2023-505971-66-00: Open-label, prospective study evaluating the efficacy and safety of Tirbanibulin 1% (Klisyri®) in the treatment of superficial basal cell carcinoma
Protocol code: 23-PP-04
Sponsor: Centre Hospitalier Universitaire De Nice (Hospital/Clinic/Other health care facility). Phase: Phase II and Phase III (Integrated). Countries: France (ongoing, recruiting).
Therapeutic area(s): Diseases [C] - Skin and Connective Tissue Diseases [C17]
Gender: Female, Male. Age: 18-64 years, 65+ years. Enrolment: 55.
Status: Ongoing, recruiting. Start date (EU): 2023-11-17. Decision date: 2023-10-05. Results received: No. Last updated: 2026-07-10.

Condition(s): Superficial Basal cell carcinoma
Product: Klisyri 10 mg/g ointment

Primary endpoint: Complete remission (CR) of BCC at the end of treatment. CR is defined as the absence of evidence of BCC clinically and on LC-OCT.
Endpoint(s): Type, frequency, severity and time of onset of side effects. Side effects will be classified into grades based on the National Cancer Institute (NCI) Common Terminology Criteria for Adverse Events (CTCAE) scale. The intensity of short-term local side effects will be assessed using the LSR score., Complete remission of BCCs after 1, 2, 3, or 4 cycles of treatment., LC-OCT measurement of BCC thickness., TSQM9 score.

Source: https://euclinicaltrials.eu/ctis-public/view/2023-505971-66-00